EU clinical trial 2024-519878-39-00: Beneficial effects of vitamin D combined with oral iron supplementation in patients with chronic heart failure and iron deficiency (VICTORID-HF TRIAL)
Protocol code: VICTORID_01
Sponsor: Universita Degli Studi Di Padova (Educational Institution). Phase: Therapeutic use (Phase IV). Countries: Italy (ongoing, recruiting).
Therapeutic area(s): Diseases [C] - Cardiovascular Diseases [C14]
Gender: Female, Male. Age: 18-64 years, 65+ years. Enrolment: 258.
Status: Ongoing, recruiting. Start date (EU): 2024-07-12. Decision date: 2025-01-21. Results received: No. Last updated: 2025-01-21.

Condition(s): Chronic heart failure; iron deficiency
Product: DIBASE 100.000 U.I./ml soluzione iniettabile, Ferinject 50 mg ferro/mL dispersione iniettabile/per infusione.

Primary endpoint: The performance of the Six-Minute Walking Test (6MWT), comparing the mean difference from baseline of the distance walked by patients in meters.
Endpoint(s): Assess in the tree-arms treatment during the study the change in Kansas City Cardiomyopathy Questionnaire(KCCQ) score, NYHA class, echocardiographic parameters (parameters of systolic and diastolic function, parietal thicknesses, and left ventricular diameters), calcium and phosphorus profile (levels of calcium, phosphate and human Fibroblast Growth Factors), incidence of fractures, glomerular filtration rate, surviving days out of hospital, hospitalizations and mortality

Source: https://euclinicaltrials.eu/ctis-public/view/2024-519878-39-00